EU clinical trial 2022-501485-22-00: A Phase 3, Open -label, Randomized Study to Compare the Efficacy and Safety of Luspatercept (ACE-536) versus Epoetin Alfa for the Treatment of Anemia Due to IPSS-R Very Low, Low or Intermediate Risk Myelodysplastic Syndromes (MDS) in ESA Naïve Subjects Who Require Red Blood Cell Transfusions.
Protocol code: ACE-536-MDS-002
Sponsor: Celgene Corp. (Pharmaceutical company). Phase: Therapeutic confirmatory (Phase III). Countries: Sweden (ongoing, recruitment ended), Hungary (ended), Spain (ongoing, recruitment ended), Belgium (ongoing, recruitment ended), Czechia (ongoing, recruitment ended), Netherlands (ended), Portugal (ended), France (ongoing, recruitment ended), Lithuania (ongoing, recruitment ended), Germany (ongoing, recruitment ended), Greece (ongoing, recruitment ended), Austria (ended), Italy (ongoing, recruitment ended), Poland (ongoing, recruitment ended).
Therapeutic area(s): Diseases [C] - Hemic and Lymphatic Diseases [C15]
Gender: Female, Male. Age: 18-64 years, 65+ years. Enrolment: 201.
Start date (EU): 2018-12-18. Decision date: 2023-07-26. Results received: No. Last updated: 2026-07-06.
Decision dates by country: PT: 2023-07-26, GR: 2023-08-22, AT: 2023-08-03, CZ: 2023-07-31, PL: 2023-08-28, NL: 2023-07-26, SE: 2023-07-26, DE: 2023-08-04, ES: 2023-07-26, HU: 2023-07-28, FR: 2023-07-26, LT: 2023-07-27, BE: 2023-07-27, IT: 2023-08-14

Condition(s): Myelodysplastic syndrome (MDS)
Product: EPREX 10,000 IU/mL solution for injection in pre-filled syringe., Reblozyl 75 mg powder for solution for injection, Reblozyl 25 mg powder for solution for injection, EPREX 40,000 IU/mL solution for injection in pre-filled syringe., EPREX 4,000 IU/mL solution for injection in pre-filled syringe.

Primary endpoint: Proportion of subjects who are RBC transfusion-free for any 12-week period associated with a concurrent mean hemoglobin increase ≥ 1.5 g/dL compared to baseline
Endpoint(s): 1. Proportion of subjects who are RBC transfusion-free from Week 1 through Week 24 2. Mean hemoglobin change over the 24-week period of Week 1 through Week 24 compared to baseline 3. Proportion of subjects achieving HI-E over any consecutive 56-day Period, 4. Time from first dose to first onset of achieving HI-E 5. Proportion of subjects who are RBC transfusion-free over a consecutive 84-day period 6. Maximum duration of RBC transfusion independence for subjects who achieve RBC-TI ≥ 84 days, 7. Time from first dose to first onset of transfusion independence ≥ 84 days 8. Time from first dose to first transfusion on treatment 9. Total number of RBC units transfused on treatment, 10. Proportion of subjects who are RBC transfusion-free over a consecutive 56-day period 11. Proportion of subjects who are RBC transfusion-free for a consecutive 24-week period in the first 48 weeks from first dose 12. Evaluation of EORTC QLQ-C30 score and FACT-An, 13. Type, frequency, severity of AEs and relationship of AEs to luspatercept/epoetin alfa 14. A Population PK model that describes the PK exposure data of luspatercept and associated variability. Exposure-response relationship for selected endpoints of efficacy and Safety, 15. Frequency of antidrug antibodies and effects on efficacy, or safety, or PK 16. Number and percentage of subjects progressing to AML; time to AML Progression 17. Time from date of randomization to death due to any cause, 18. Evaluation of biomarkers that may potentially impact luspatercept efficacy, predict response or relapse, help to better understand MOA and/or provide further prognostic classification of MDS subtypes. Molecular markers (eg, SF3B1) include evaluation of MDSassociated gene mutations and their impact on drug efficacy, clinical response or relapse, drug MOA and prognostication of MDS, 19. Evaluation of healthcare resource use (eg, hospitalization) associated with investigational product (IP) during study 20. Description of QUALMS-P and Treatment Satisfaction

Source: https://euclinicaltrials.eu/ctis-public/view/2022-501485-22-00